EU clinical trial 2024-516632-99-00: MITO 25.1: A randomized, molecular driven phase II trial of Carboplatin-Paclitaxel-Bevacizumab vs Carboplatin-Paclitaxel-Bevacizumab-Rucaparib vs Carboplatin-Paclitaxel-Rucaparib, selected according to HRD status, in patients with advanced (stage III B-C-IV) ovarian, primary peritoneal and Fallopian tube cancer preceded by a phase I dose escalation study on Rucaparib-Bevacizumab combination
Protocol code: MITO 25.1
Sponsor: Fondazione Policlinico Universitario Agostino Gemelli IRCCS (Hospital/Clinic/Other health care facility). Phase: Therapeutic exploratory (Phase II). Countries: Italy (ongoing, recruitment ended).
Therapeutic area(s): Diseases [C] - Neoplasms [C04]
Gender: Female. Age: 18-64 years, 65+ years. Enrolment: 300.
Status: Ongoing, recruitment ended. Start date (EU): 2021-03-17. Decision date: 2024-11-19. Results received: No. Last updated: 2025-06-10.

Condition(s): Advanced (stage III B-C-IV) ovarian, primary peritoneal and Fallopian tube cancer.
Product: Rubraca 300 mg film-coated tablets, Rubraca 200 mg film-coated tablets, BEVACIZUMAB, Rubraca 250 mg film-coated tablets, CARBOPLATIN, PACLITAXEL

Primary endpoint: Phase I: Maximum Tolerated Dose (MTD): defined as the maximum dose at which no limiting toxicities occurr (see belove the definition of limiting toxicities) to recommend for the Phase II randomized design of the trial, Phase II: Progression-free survival, defined as the time from the date of randomization to the date of documented progressive disease, recurrence or death (whichever occurs first) in patients treated according to HRD status.
Endpoint(s): Phase I: Toxicity of the Rucaparib-Bevacizumab combination in terms of haematologic and non haematologic events. Toxicity will be evaluated according to U.S. NCI Common Toxicity Criteria version 5.0, Phase I: Pharmacokinetic parameter in patient receiving the combination of Rucaparib and Bevacizumab, Phase II: Overall survival defined as the time from the date of randomization to the date of death in patients treated accordinf to HRD status, Phase II: Progression-free survival 2 (PFS2) defined as time from randomisation to second objective disease progression or death in patients treated accordinf to HRD status, Phase II: To compare the time from randomization to first subsequent therapy or death (TFST) in patients treated according to HRD status, Phase II: Time to second subsequent therapy (TSST) defined as time from randomisation to the initiation of second subsequent therapy or death in patients treated according to HRD status, Phase II: Best target lesion response, defined as best change in sum of the target lesions from baseline to disease progression or by the modifications of CA 125 according to GCIG criteria, Phase II: Adverse Events and laboratory abnormalities evaluated according to CTCAE version 5.0, Phase II: Patient-reported outcome (PRO) of disease-related symptoms utilizing Functional Assessment of Cancer Therapy-Ovarian (FACT-O) and Euro-Quality of Life 5D (EQ-5D) tool

Source: https://euclinicaltrials.eu/ctis-public/view/2024-516632-99-00